EU clinical trial 2024-511798-31-00: A Phase 1/2, Open-label Study Evaluating the Safety, Tolerability, Pharmacokinetics, Pharmacodynamics, and Efficacy of Sotorasib (AMG 510) Monotherapy in Subjects With Advanced Solid Tumors With KRAS p.G12C Mutation and Sotorasib (AMG 510) Combination Therapy in Subjects With Advanced NSCLC With KRAS p.G12C Mutation (CodeBreaK 100)
Protocol code: 20170543
Sponsor: Amgen Inc. (Pharmaceutical company). Phase: Phase I and Phase II (Integrated)- First administration to humans. Countries: Spain (ended), France (ended), Belgium (ended), Hungary (ended), Romania (ended), Portugal (ended), Austria (ended), Greece (ended).
Therapeutic area(s): Diseases [C] - Neoplasms [C04]
Gender: Female, Male. Age: 18-64 years, 65+ years. Enrolment: 246.
Status: Ended. Start date (EU): 2019-05-31. End date (EU): 2026-05-28. Decision date: 2024-04-18. Results received: No. Last updated: 2026-06-03.
Decision dates by country: HU: 2024-04-19, PT: 2024-04-18, ES: 2024-04-22, FR: 2024-04-23, RO: 2024-04-23, BE: 2024-04-19, AT: 2024-04-23, GR: 2024-06-17

Condition(s): KRAS p.G12C Mutant Advanced Solid Tumors
Product: SOTORASIB

Primary endpoint: Phase 1 Part 1a and Part 2a Monotherapy Cohorts: Incidence of treatment emergent adverse events, treatment-related adverse events, and clinically significant changes in vital signs, physical examinations, electrocardiograms (ECGs), and clinical laboratory tests, Phase 1 Part 1a and Part 2a Monotherapy Cohorts: Incidence of dose-limiting toxicity (DLT), Phase 1 Part 1b and Part 2b Monotherapy Cohorts and Phase 1 Part 1d and Part 2d Monotherapy Cohorts: Incidence of DLTs, treatment emergent adverse events, treatment-related adverse events, and changes in vital signs, ECGs, and clinical laboratory tests, Phase 1 Part 1c and Part 2c Pembrolizumab Combination Therapy Cohorts: Incidence of DLTs, treatment emergent adverse events, treatment-related adverse events, and clinically significant changes in vital signs, physical examinations, ECGs, and clinical laboratory tests, Phase 1 Part 2e Previously Untreated Metastatic NSCLC Monotherapy Cohort: Incidence of DLTs, treatment emergent adverse events, treatment-related adverse events, and changes in vital signs, ECGs, and clinical laboratory tests, Phase 1 Part 2e Previously Untreated Metastatic NSCLC Monotherapy Cohort: Objective response (OR = complete response [CR] + partial response [PR]), duration of response (DOR), disease control (CR + PR + stable disease [SD]), duration of SD, and time to response measured by CT or MRI and assessed per RECIST 1.1. Response will be assessed by BICR. CR and PR require confirmatory CT or MRI repeat assessment at least 4 weeks after the first detection of response., Phase 2 Part A – NSCLC, CRC, and other tumor types (AMG 510 monotherapy): Objective response (OR = CR + PR), measured by CT or MRI and assessed per RECIST 1.1. Response will be assessed by BICR. Complete response and PR require confirmatory CT or MRI repeat assessment at least 4 weeks after the first detection of response., Phase 2 Part B – NSCLC (Dose Comparison Study): Objective response (ORR = CR + PR), measured by CT or MRI and assessed per RECIST 1.1. Response will be assessed by BICR. Complete response and PR require confirmatory CT or MRI repeat assessment at least 4 weeks after the first detection of response., Phase 2 Part B – NSCLC (Dose Comparison Study): Treatment emergent adverse events (TEAE), grade greater/equal to 3 TEAE, serious adverse event (SAEs), and events of interest (EOIs)
Endpoint(s): Phase 1 Part 1a and Part 2a Monotherapy Cohorts (QD), Phase 1 Part 1b and Part 2b Monotherapy Cohorts (BID), and Phase 1 Part 1d and Part 2d Monotherapy Cohorts (QD): PK parameters of AMG 510 including, but not limited to, maximum plasma concentration (Cmax), time to achieve Cmax (tmax), and area under the plasma concentration-time curve (AUC), Phase 1 Part 1a and Part 2a Monotherapy Cohorts (QD), Phase 1 Part 1b and Part 2b Monotherapy Cohorts (BID), and Phase 1 Part 1d and Part 2d Monotherapy Cohorts (QD): OR, DOR, disease control, progression free survival (PFS), duration of stable disease, and TTR measured by CT or MRI and assessed per RECIST 1.1. Response will be assessed by BICR. Complete response and PR require confirmatory CT or MRI repeat assessment at least 4 weeks after the first detection of response., Phase 1 Part 1a and Part 2a Monotherapy Cohorts (QD), Phase 1 Part 1b and Part 2b Monotherapy Cohorts (BID), and Phase 1 Part 1d and Part 2d Monotherapy Cohorts (QD): Overall survival (OS), Phase 1 Part 1a and Part 2a Monotherapy Cohorts (QD), Phase 1 Part 1b and Part 2b Monotherapy Cohorts (BID), and Phase 1 Part 1d and Part 2d Monotherapy Cohorts (QD): PK parameters of AMG 510 including, but not limited to, Cmax, tmax, and AUC in the fed and/or fasted state, Phase 1 Part 1a and Part 2a Monotherapy Cohorts (QD), Phase 1 Part 1b and Part 2b Monotherapy Cohorts (BID), and Phase 1 Part 1d and Part 2d Monotherapy Cohorts (QD): AMG 510 exposure/QTc interval relationship, Phase 1 Part 1c and Part 2c Pembrolizumab Combination Therapy Cohorts: PK parameters of AMG 510 including, but not limited to, Cmax, tmax, and AUC, Phase 1 Part 1c and Part 2c Pembrolizumab Combination Therapy Cohorts: OR, DOR, disease control, PFS, duration of stable disease, and TTR measured by CT or MRI and assessed per RECIST 1.1. Response will be assessed by BICR. Complete response and PR require confirmatory CT or MRI repeat assessment at least 4 weeks after the first detection of response., Phase 1 Part 1c and Part 2c Pembrolizumab Combination Therapy Cohorts: OS, Phase 1 Part 2e Previously Untreated Metastatic NSCLC Monotherapy Cohort: PK parameters of AMG 510 including, but not limited to Cmax, tmax, and AUC, Phase 1 Part 2e Previously Untreated Metastatic NSCLC Monotherapy Cohort: PK parameters for midazolam including, but not limited to: Cmax, AUC, clearance, and t1/2, Phase 1 Part 2e Previously Untreated Metastatic NSCLC Monotherapy Cohort: - OS - PFS, Phase 2 Part A – NSCLC, CRC, and other tumor types (AMG 510 monotherapy): - Duration of response (DOR) - Disease control - Time to response (TTR) - Progression-free survival (PFS) - Overall survival (OS) - 6-month PFS and 12 month PFS - 12 month OS, Phase 2 Part A – NSCLC, CRC, and other tumor types (AMG 510 monotherapy): Incidence and severity of adverse events, Phase 2 Part A – NSCLC, CRC, and other tumor types (AMG 510 monotherapy): PK parameters of AMG 510 including, but not limited to, Cmax, tmax, and AUC, Phase 2 Part B – NSCLC (Dose Comparison Study): - Duration of response (DOR) - Disease control (DCR = CR + PR + SD) - Depth of response (best percent change from baseline in lesion sum diameters) - Time to response (TTR) - Progression free survival (PFS) - Overall survival (OS), Phase 2 Part B – NSCLC (Dose Comparison Study): PK parameters of AMG 510 including, but not limited to, Cmax and AUC, Phase 2 Part B – NSCLC: Changes in cancer-specific symptoms and overall health status using subject reported outcome instruments: Impact of treatment on disease related symptoms and HRQOL (instruments; EORTC QLQ C30 + disease-specific modules QLQ LC13 and NSCLC SAQ for NSCLC; PGIS and PGIC in cough, dyspnea and chest pain among NSCLC subjects). (cont.), Phase 2 Part B – NSCLC: (cont. from prev. point) Treatment-related symptoms and impact on the subject (EORTC QLQ C30, selected questions from the PRO-CTCAE library and a single item about symptom bother, item GP5 of the FACT-G)., Phase 2 Part B – NSCLC (Dose Comparison Study): Physical function (instrument: EORTC QLQ-C30, Physical function scale)

Source: https://euclinicaltrials.eu/ctis-public/view/2024-511798-31-00